EU clinical trial 2023-504012-16-00: A Phase 1/2, First-in-Human, Open-Label, Dose-Escalation Study of TAK-280 in Patients With Unresectable Locally Advanced or Metastatic Cancer
Protocol code: TAK-280-1501
Sponsor: Takeda Development Center Americas Inc. (Pharmaceutical company). Phase: Phase I and Phase II (Integrated)- First administration to humans. Countries: Spain (ended), France (ended).
Therapeutic area(s): Diseases [C] - Neoplasms [C04]
Gender: Female, Male. Age: 18-64 years, 65+ years. Enrolment: 56.
Status: Ended. Start date (EU): 2024-04-29. End date (EU): 2025-07-28. End date: 2025-07-29. Decision date: 2024-01-26. Results received: Yes. Last updated: 2025-07-18.
Decision dates by country: FR: 2024-12-11, ES: 2024-01-26

Condition(s): Unresectable Locally Advanced or Metastatic Cancer
Product: TAK-280, SILTUXIMAB, TOCILIZUMAB, TOCILIZUMAB, SILTUXIMAB, TOCILIZUMAB

Primary endpoint: 01. Number of Participants With Treatment- emergent Adverse Events (TEAEs) [Time Frame: Up to approximately 37 months], 02. Number of Participants With Dose Limiting Toxicities (DLTs). DLT evaluation period is defined as the time between the initial dose of TAK-280 and Cycle 1 Day 28. [Time Frame: From start of the initial dose up to Cycle 1 Day 28]
Endpoint(s): 01. Maximum Observed Plasma Concentration (Cmax) of TAK-280. Cmax of TAK-280 will be reported. [Time Frame: Pre-dose and at multiple time points post-dose on Days 1, 2, 3, 8, 15, 22 up to the end of treatment (Up to 14 months)], 02. Area Under Plasma Concentration-Time Curve (AUC) of TAK- 280. AUC of TAK-280 will be reported. [Time Frame: Pre-dose and at multiple time points post-dose on Days 1, 2, 3, 8, 15, 22 up to the end of treatment (Up to 14 months)], 03. Time to Reach Maximum Observed Plasma Concentration (tmax) of TAK-280. tmax of TAK-280 will be reported. [Time Frame: Pre-dose and at multiple time points post-dose on Days 1, 2, 3, 8, 15, 22 up to the end of treatment (Up to 14 months)], 04. Terminal Disposition Phase Half-Life (t1/2) of TAK-280. t1/2 of TAK-280 will be reported. [Time Frame: Pre-dose and at multiple time points post-dose on Days 1, 2, 3, 8, 15, 22 up to the end of treatment (Up to 14 months)], 05. Total Clearance (CL) of TAK-280. CL of TAK-280 will be reported. [Time Frame: Pre-dose and at multiple time points post-dose on Days 1, 2, 3, 8, 15, 22 up to the end of treatment (Up to 14 months)], 06. Volume of Distribution at Steady State After Intravenous Administration (Vss) of TAK-280. Vss of TAK-280 will be reported. [Time Frame: Pre-dose and at multiple time points post-dose on Days 1, 2, 3, 8, 15, 22 up to the end of treatment (Up to 14 months)], 07. Percentage of Participants With Confirmed Overall Response Rate (ORR) Based on Response Evaluation Criteria in Solid Tumors Version 1.1 (RECIST V1.1). ORR is defined as the percentage of participants who achieve confirmed complete response (CR) or partial response (PR) based on RECIST V1.1 as determined by the investigator during the study. [Time Frame: Up to approximately 37 months], 08. Duration of Response (DOR) Based on RECIST V1.1. DOR is defined as the time from the date of first documentation of a PR or better to the date of first documentation of progressive disease (PD) or death due to any cause, whichever occurs first, for participants with a confirmed response (PR or better). [Time Frame: Up to approximately 37 months], 09. Progression Free Survival (PFS). PFS is defined as the time from the date of the first dose of TAK-280 to the date of first documentation of PD or death due to any cause, whichever occurs first. [Time Frame: From start of first dose to disease progression or death, whichever occurred first (up to approximately 37 months)], 10. Overall Survival (OS). OS is defined as the time from the date of the first dose of TAK-280 to the date of death due to any cause. [Time Frame: From start of first dose of study drug up to death (up to approximately 37 months)], 11. Disease Control Rate. Disease control rate is defined as the percentage of participants who achieve PR or CR or SD, with a duration of greater than or equal to (>=) 2 consecutive scans. [Time Frame: Up to approximately 37 months], 12. Percentage of Participants With Metastatic Castration-resistant Prostate Cancer (mCRPC) Having Prostate-Specific Antigen (PSA) Response. PSA response is defined as PSA reduction from baseline of >= 50 percent (%) and confirmed at least 3 weeks later. [Time Frame: Up to approximately 37 months], 13. Duration of PSA Response in Participants With mCRPC. Duration of PSA response is defined as the time from first PSA response to first documented PSA progression. [Time Frame: Up to approximately 37 months], 14. Time to PSA Progression in Participants With mCRPC. Time to PSA progression is defined as the time from the date of first dose of TAK-280 to the date that an increase of 25% or more and absolute increase of 2 nanograms/milliliter (ng/mL) or more from the nadir. [Time Frame: Up to approximately 37 months], 15. Percentage of Participants With mCRPC Having PSA Reductions of >= 50% up to 6 Months [Time Frame: Baseline up to 6 months], 16. Percentage of Participants who Develop Positive Induced Antidrug Antibody (ADA) for TAK-280 [Time Frame: Cycle 1 to 5: pre-dose (Each cycle= 28 days)], 17. Percentage of Participants who Developed Neutralizing Antibody (NAb) Titers for TAK-280 [Time Frame: Cycle 1 to 5: pre-dose (Each cycle= 28 days)]

Source: https://euclinicaltrials.eu/ctis-public/view/2023-504012-16-00